EU clinical trial 2024-510783-23-00: A Phase 1/2 Study of REGN4018 (Ubamatamab), a MUC16xCD3 Bispecific Antibody, Administered Alone or in Combination with Cemiplimab in Patients with Recurrent Ovarian Cancer or Other Recurrent MUC16+ Cancers
Protocol code: R4018-ONC-1721
Sponsor: Regeneron Pharmaceuticals Inc. (Pharmaceutical company). Phase: Phase I and Phase II (Integrated)- First administration to humans. Countries: Belgium (ongoing, recruiting), Spain (ongoing, recruiting), Italy (ongoing, recruiting), Netherlands (ongoing, recruiting), France (ongoing, recruiting).
Therapeutic area(s): Diseases [C] - Neoplasms [C04]
Gender: Female. Age: 18-64 years, 65+ years. Enrolment: 237.
Status: Ongoing, recruiting. Start date (EU): 2020-10-29. Decision date: 2024-06-25. Results received: No. Last updated: 2026-03-26.
Decision dates by country: NL: 2024-07-11, BE: 2024-06-25, FR: 2024-07-09, IT: 2024-07-09, ES: 2024-06-28

Condition(s): Fallopian Tube Cancer, Endometrial Cancer, Ovarian Cancer, Primary Peritoneal Cancer
Product: Ubamatamab, TOCILIZUMAB, Ubamatamab, Kevzara 175 mg/ml solution for injection, CEMIPLIMAB, LIBTAYO 350 mg concentrate for solution for infusion., Sarilumab

Primary endpoint: In the Dose Escalation Phase: Number of participants with Dose-limiting toxicity (DLTs) for ubamatamab monotherapy and in combination with cemiplimab, In the Dose Escalation Phase: Number of participants with Treatment-emergent adverse event (TEAE)s (including immune (imAEs)) for ubamatamab monotherapy and in combination with cemiplimab, In the Dose Escalation Phase: Number of participants with serious adverse events (SAEs) for ubamatamab monotherapy and in combination with cemiplimab, In the Dose Escalation Phase: Number of deaths for ubamatamab monotherapy and in combination with cemiplimab, In the Dose Escalation Phase: Number of participants with laboratory abnormalities (grade 3 or higher per Common Terminology Criteria for Adverse Events [CTCAE]) for ubamatamab monotherapy and in combination with cemiplimab, In the Dose Escalation Phase: Concentration of REGN4018 in serum over time for ubamatamab monotherapy and in combination with cemiplimab, In the Dose Expansion Phase: Objective response rate (ORR) defined by Response Evaluation Criteria in Solid Tumors (RECIST 1.1) for ubamatamab monotherapy and in combination with cemiplimab
Endpoint(s): In the Dose Escalation Phase: ORR based on RECIST 1.1 for ubamatamab monotherapy and in combination with cemiplimab, In the Dose Expansion Phase: Number of participants with TEAEs (including imAEs) for ubamatamab monotherapy and in combination with cemiplimab, In the Dose Expansion Phase: Number of participants with SAEs for ubamatamab monotherapy and in combination with cemiplimab, In the Dose Expansion Phase: Number of deaths for ubamatamab monotherapy and in combination with cemiplimab, In the Dose Expansion Phase: Number of participants with laboratory abnormalities (grade 3 or higher per CTCAE) for ubamatamab monotherapy and in combination with cemiplimab, In the Dose Expansion Phase: Concentration of ubamatamab in serum over time for ubamatamab monotherapy and in combination with cemiplimab, In the Dose Expansion Phase: Change from baseline in QoL as measured by the European Organisation for Research and Treatment of Cancer (EORTC) Quality of Life Questionnaire (QLQ)-C30 GHS/QoL score for ubamatamab monotherapy and in combination with cemiplimab, In the Dose Expansion Phase: Change from baseline in physical functioning as measured by the EORTC QLQ-C30 physical functioning score for ubamatamab monotherapy and in combination with cemiplimab, In the Dose Expansion Phase: Change from baseline in abdominal symptoms as measured by the Measure of Ovarian Symptoms and Treatment (MOST)-Abdominal index score (Not applicable to Endometrial Cancer Cohort) for ubamatamab monotherapy and in combination with cemiplimab, In the Dose Expansion Phase: Time to deterioration in GHS/QoL, physical functioning, and abdominal symptoms for ubamatamab monotherapy and in combination with cemiplimab, In the Dose Expansion Phase: Change from baseline in QoL as measured by EQ-5D for ubamatamab monotherapy and in combination with cemiplimab, In the Dose Escalation and Dose Expansion Phase: ORR based on iRECIST for ubamatamab monotherapy and with cemiplimab, In the Dose Escalation and Dose Expansion Phase: Best overall response (BOR) based on RECIST 1.1 and iRECIST for ubamatamab monotherapy and in combination with cemiplimab, In the Dose Escalation and Dose Expansion Phase: Duration of response (DOR) based on RECIST 1.1 and iRECIST for ubamatamab monotherapy and in combination with cemiplimab, In the Dose Escalation and Dose Expansion Phase: Disease control rate based on RECIST 1.1 and iRECIST for ubamatamab monotherapy and in combination with cemiplimab, In the Dose Escalation and Dose Expansion Phase: Progression-free survival (PFS) based on RECIST 1.1 and iRECIST for ubamatamab monotherapy and in combination with cemiplimab, In the Dose Escalation and Dose Expansion Phase: Complete Response (CR) rate for ubamatamab monotherapy and in combination with cemiplimab, In the Dose Escalation and Dose Expansion Phase: Cancer antigen-125 (CA-125) response for ubamatamab monotherapy and in combination with cemiplimab, In the Dose Escalation and Dose Expansion Phase: Presence or absence of anti-drug antibodies against ubamatamab and cemiplimab

Source: https://euclinicaltrials.eu/ctis-public/view/2024-510783-23-00